EU clinical trial 2023-505313-24-00: A randomized, placebo-controlled, double-blind, multi-center trial to assess efficacy and safety of octreotide subcutaneous depot (CAM2029) in patients with symptomatic polycystic liver disease
Protocol code: HS-20-677
Sponsor: Camurus AB (Pharmaceutical company). Phase: Phase II and Phase III (Integrated). Countries: Germany (ongoing, recruitment ended), Netherlands (ongoing, recruitment ended), Belgium (ongoing, recruitment ended).
Therapeutic area(s): Diseases [C] - Digestive System Diseases [C06]
Gender: Female, Male. Age: 18-64 years, 65+ years. Enrolment: 31.
Status: Ongoing, recruitment ended. Start date (EU): 2022-09-30. Decision date: 2023-08-01. Results received: No. Last updated: 2026-03-13.
Decision dates by country: DE: 2023-08-02, BE: 2023-08-01, NL: 2023-08-03

Condition(s): Polycystic liver disease
Product: CAM2029 (octreotide subcutaneous depot), Cam2029 (octreotide subcutaneous depot) - Placebo

Primary endpoint: Change from baseline to Week 53 in height-adjusted total liver volume (htTLV) as determined by magnetic resonance imaging (MRI) volumetry
Endpoint(s): Change from baseline to Week 53 in the Polycystic Liver Disease Symptoms (PLD-S) measure score, Change from baseline in htTLV as determined by MRI volumetry, Change from baseline in the PLD-S measure score, Change from baseline in height-adjusted total kidney volume (htTKV) as measured by MRI volumetry, Change from baseline in estimated glomerular filtration rate (eGFR), assessed by the Chronic Kidney Disease Epidemiology Collaboration (CKD-EPI) cystatin C equation using serum concentrations of creatinine and cystatin C, Change from baseline in the Polycystic Liver Disease Impact (PLD-I) measure score, Change from baseline in the Clinical Global Impression of Severity (CGI-S) score, Change from baseline in the Patient Global Impression of Severity (PGI-S) score, Change from baseline in the Patient Global Impression of Change (PGI-C) score, Change from baseline in the Short Form-36 (SF-36) scores, Change from baseline in the Polycystic Liver Disease Questionnaire (PLD-Q) score, Incidence of adverse events (AEs), Changes from baseline in laboratory values, vital signs and electrocardiogram (ECG) readings, Octreotide plasma concentrations over time, Change from baseline in total liver cyst volume determined by MRI volumetry

Source: https://euclinicaltrials.eu/ctis-public/view/2023-505313-24-00